EU clinical trial 2023-505253-41-01: Enhancing social attunement in autism via interpersonal sensorimotor synchronization therapy combined with single-dose intranasal oxytocin administration
Protocol code: S67699
Sponsor: UZ Leuven (Hospital/Clinic/Other health care facility). Phase: Therapeutic confirmatory (Phase III). Countries: Belgium (ongoing, recruiting).
Therapeutic area(s): Psychiatry and Psychology [F] - Psychological Phenomena [F02]; Psychiatry and Psychology [F] - Behavior and Behavior Mechanisms [F01]; Psychiatry and Psychology [F] - Behavioral Disciplines and Activities [F04]
Gender: Female, Male. Age: 0-17 years. Enrolment: 140.
Status: Ongoing, recruiting. Start date (EU): 2024-06-18. Decision date: 2024-03-05. Results received: No. Last updated: 2026-07-06.

Condition(s): Autism Spectrum Disorder (ASD)
Product: Syntocinon 40 IE/ml neusspray, oplossing, Sodium Chloride Nasal Drops 0.9% (Fagron)

Primary endpoint: The primary endpoint of this project is the change from baseline treatment effects on dyadic attunement in children with ASD and the experimenter, determined by multimodal measures of neurophysiological and behavioral responses as defined in the study protocol, during screen-based and real-life social interaction paradigms
Endpoint(s): The secondary endpoint of this project is the change from baseline treatment effects on post-intervention endogenous oxytocin and cortisol levels measured in saliva samples

Source: https://euclinicaltrials.eu/ctis-public/view/2023-505253-41-01